EU clinical trial 2025-523871-44-00: A Phase 3, Randomized, Double-Blind, Placebo-Controlled Parallel Study to Evaluate the Efficacy and Safety of Enpatoran in Participants with Active Cutaneous Manifestations of Lupus Erythematosus With or Without Systemic Disease Receiving Standard of Care
Protocol code: MS504908_0001
Sponsor: Merck Healthcare KGaA (Pharmaceutical company). Phase: Therapeutic confirmatory (Phase III). Countries: Spain (authorised, recruitment pending), Belgium (authorised, recruitment pending), France (authorised, recruitment pending), Germany (authorised, recruitment pending), Slovakia (authorised, recruitment pending), Romania (authorised, recruitment pending), Bulgaria (authorised, recruitment pending), Italy (authorised, recruitment pending), Poland (authorised, recruitment pending), Greece (authorised, recruitment pending).
Therapeutic area(s): Diseases [C] - Immune System Diseases [C20]; Diseases [C] - Skin and Connective Tissue Diseases [C17]
Gender: Female, Male. Age: 18-64 years, 65+ years. Enrolment: 54.
Status: Authorised, recruitment pending. Decision date: 2026-06-29. Results received: No. Last updated: 2026-07-06.
Decision dates by country: BE: 2026-06-29, BG: 2026-07-03, FR: 2026-07-03, DE: 2026-07-02, GR: 2026-07-02, IT: 2026-07-01, RO: 2026-07-06, ES: 2026-06-30, PL: 2026-07-06, SK: 2026-06-30

Condition(s): Cutaneous Manifestations of Lupus Erythematosus With or Without Systemic Disease
Product: Placebo to match Enpatoran, Enpatoran

Primary endpoint: Percentage of Participants With Cutaneous Lupus Erythematosus Disease Area and Severity Index (CLASI) 70 Response, Defined as >=70 Percent (%) Decrease in CLASI-A Score From Baseline at Week 24
Endpoint(s): Percentage of Participants With British Isles Lupus Assessment Group Based Composite Lupus Assessment (BICLA) Response at Week 24., Number of Participants With Treatment Emergent adverse events (TEAEs), Serious Adverse Events (SAEs), and Adverse Events of Special Interest (AESI) [ Time Frame: From Day 1 to Week 24 ]., Number of Participants With Abnormal (greater than and equal to [>=] Grade 3) laboratory parameters [ Time Frame: From Day 1 to Week 24 ]., Percentage of Participants With CLASI-A less than and equal to (<=) 3 at Week 24., Percentage of Participants WithCLASI-50 Response, Defined as>=50% Decrease in CLASI-A Score From Baseline at Weeks 4 and 24., Percentage of Participants With Clinically Meaningful Corticosteroid (CS) Reduction [ Time Frame: Day 1 up to Week 12 and thereafter upto Week 24 ].

Source: https://euclinicaltrials.eu/ctis-public/view/2025-523871-44-00